EU clinical trial 2023-505781-28-00: FILOWM4-WaZaBi: "Open label phase 2 study evaluating the efficacy and tolerance of a zanubrutinib and BGB-11417 combination in patients previously treated for Waldenström macroglobulinemia"
Protocol code: FILOWM4-WaZaBi
Sponsor: French Innovative Leukemia Organization (Laboratory/Research/Testing facility). Phase: Therapeutic exploratory (Phase II). Countries: France (ongoing, recruiting).
Therapeutic area(s): Diseases [C] - Hemic and Lymphatic Diseases [C15]
Gender: Female, Male. Age: 18-64 years, 65+ years. Enrolment: 102.
Status: Ongoing, recruiting. Start date (EU): 2026-01-20. Decision date: 2024-06-27. Results received: No. Last updated: 2026-03-04.

Condition(s): Patients with Waldenstrom macroglobulinemia and have received at least one prior line of treatment

Source: https://euclinicaltrials.eu/ctis-public/view/2023-505781-28-00